EU clinical trial 2024-519319-32-00: A seamless Phase 1/2, observer-blind, randomized, placebo-controlled, multicenter study to assess the safety and immunogenicity of a UTI vaccine when administered to adults 18 through 64 years of age and clinical efficacy when administered to females 18 through 64 years of age.
Protocol code: 219685
Sponsor: GlaxoSmithKline Biologicals (Pharmaceutical company). Phase: Phase I and Phase II (Integrated)- First administration to humans. Countries: Belgium (ongoing, recruitment ended), Spain (ongoing, recruitment ended).
Therapeutic area(s): Diseases [C] - Bacterial Infections and Mycoses [C01]
Gender: Female, Male. Age: 18-64 years. Enrolment: 200.
Status: Ongoing, recruitment ended. Start date (EU): 2025-08-27. Decision date: 2025-04-22. Results received: No. Last updated: 2026-03-26.
Decision dates by country: BE: 2025-04-22, ES: 2025-04-25

Condition(s): Urinary Tract Infections
Product: sterile saline solution (0.9% w/v solution of NaCl in water).

Primary endpoint: For participants in both parts of the study (Part 1 [SLI] and Part 2 [PoP]), occurrence of: • solicited administration site and systemic AEs during the 7 days post-Dose 1 and post-Dose 2, • any unsolicited AEs during the 30 days post-Dose 1 and post Dose 2, • any immediate unsolicited AEs in the 60 minutes post-Dose 1 and post-Dose 2. • SAEs, pIMDs, MAAEs, and AEs leading to study withdrawal until Day 426 (i.e., end of follow-up)., For participants in the Part 1 of the study (SLI): • Occurrence of hematological and biochemical laboratory abnormalities, and changes from the baseline values, at 7 days after the day of Dose 1 and Dose 2 compared to pre-dose values (i.e., on Day 8 and Day 68, compared to Day 1# and Day 61, respectively)., For participants in the Part 2 of the study (PoP): • First occurrence of a urine culture confirmed UTI due to E. coli from 14 days (Day 75) up to 12 months (Day 426) post-Dose 2.

Source: https://euclinicaltrials.eu/ctis-public/view/2024-519319-32-00